EU clinical trial 2023-507925-41-00: Phase III multicenter, prospective, randomized, double-blind study comparing the efficacy and safety of therapy for scabies with two differently concentrated permethrin creams.
Protocol code: SKABUP
Sponsor: INFECTOPHARM Arzneimittel und Consilium GmbH (Pharmaceutical company). Phase: Therapeutic confirmatory (Phase III). Countries: Germany (ongoing, recruiting).
Therapeutic area(s): Diseases [C] - Parasitic Diseases [C03]
Gender: Female, Male. Age: 0-17 years, 18-64 years, 65+ years. Enrolment: 218.
Status: Ongoing, recruiting. Start date (EU): 2024-08-14. Decision date: 2024-07-05. Results received: No. Last updated: 2026-07-09.
Decision dates by country: DE: 2024-07-09

Condition(s): Scabies
Product: Permethrin, InfectoScab® 5 % Crème

Primary endpoint: The primary endpoint of this study was defined as the clinical efficacy (yes/no) after completion of treatment (depending on the success of treatment with V1 after 14 or after the second treatment after a total of 28 days).

Source: https://euclinicaltrials.eu/ctis-public/view/2023-507925-41-00